EU clinical trial 2023-507071-21-01: A clinical trial for patients with relapsed or refractory multiple myeloma, using an experimental drug called ISB 2001 for the first time in humans
Protocol code: ISB 2001-101
Sponsor: IGI Therapeutics S.A. (Pharmaceutical company). Phase: Human Pharmacology (Phase I)- First administration to humans. Countries: France (ongoing, recruiting), Norway (ongoing, recruiting), Spain (ongoing, recruiting), Italy (ongoing, recruiting).
Therapeutic area(s): Diseases [C] - Hemic and Lymphatic Diseases [C15]
Gender: Female, Male. Age: 18-64 years, 65+ years. Enrolment: 85.
Status: Ongoing, recruiting. Start date (EU): 2025-08-14. Decision date: 2025-06-16. Results received: No. Last updated: 2026-06-01.
Decision dates by country: ES: 2025-06-17, IT: 2025-06-18, NO: 2025-06-19, FR: 2025-06-16

Condition(s): Relapsed/Refractory Multiple Myeloma

Source: https://euclinicaltrials.eu/ctis-public/view/2023-507071-21-01